EU clinical trial 2024-512946-41-00: A Phase 3, Multicenter, Randomized, Double-blind, Placebo-Controlled Study with an Open-Label Extension to Evaluate the Efficacy, Safety, and Tolerability of Atogepant for the Preventive Treatment of Menstrual Migraine
Protocol code: M24-859
Sponsor: AbbVie Deutschland GmbH & Co. KG (Pharmaceutical company). Phase: Therapeutic confirmatory (Phase III). Countries: Portugal (ongoing, recruitment ended), Poland (ongoing, recruitment ended), Italy (ongoing, recruitment ended), Hungary (ended), Czechia (ongoing, recruitment ended), Germany (ongoing, recruitment ended), Spain (ongoing, recruitment ended).
Therapeutic area(s): Diseases [C] - Nervous System Diseases [C10]
Gender: Female. Age: 18-64 years. Enrolment: 267.
Start date (EU): 2025-03-05. Decision date: 2025-02-19. Results received: No. Last updated: 2026-06-15.
Decision dates by country: DE: 2025-02-20, IT: 2025-02-24, HU: 2025-03-03, PL: 2025-03-02, CZ: 2025-04-15, ES: 2025-08-04, PT: 2025-02-19

Condition(s): Menstrual Migraine
Product: Atogepant, Placebo for Atogepant

Primary endpoint: The primary endpoint is the change from baseline (CFB) in number of migraine days occurring during the perimenstrual period (PMP) averaged across 3 menstrual cycles during the double-blind (DB) period.
Endpoint(s): CFB in number of migraine days (with moderate or severe headache) during the PMP averaged across 3 menstrual cycles during the DB period, 50% or above reduction from baseline in the number of migraine days averaged across 3 PMPs during the DB period, CFB in number of acute medication use days during the PMP averaged across 3 menstrual cycles during the DB period, CFB in number of moderate or severe headache days during the PMP averaged across 3 menstrual cycles during the DB period, 100% reduction from baseline in the number of migraine days averaged across 3 PMPs during the DB period, No disability/mild impairment for 100% of PMP days (assessed by FDS) across 3 menstrual cycles during the DB period, CFB in number of headache days during the PMP averaged across 3 menstrual cycles during the DB period, Not difficult at all/a little difficult in thinking clearly for 100% of PMP days (assessed by CFS) across 3 menstrual cycles during the DB period.

Source: https://euclinicaltrials.eu/ctis-public/view/2024-512946-41-00